EU clinical trial 2023-508397-29-00: A 60 month, single-arm, proof-of-concept study to induce allogeneic tolerance in deceased donor liver transplant recipients using siplizumab, an anti-CD2 antibody in combination with cyclophosphamide and splenectomy.
Protocol code: TCD601G201
Sponsor: Itb-Med AB (Pharmaceutical company). Phase: Therapeutic exploratory (Phase II). Countries: Sweden (temporarily halted).
Therapeutic area(s): Phenomena and Processes [G] - Immune system processes [G12]
Gender: Female, Male. Age: 18-64 years, 65+ years. Enrolment: 12.
Status: Temporarily halted. Start date (EU): 2022-06-29. Decision date: 2024-07-23. Results received: No. Last updated: 2026-04-01.

Condition(s): Prophylaxis against liver allograft rejection following tolerance induction

Primary endpoint: The proportion of patients who are free from immunosuppression at Month 30 post-transplant.
Endpoint(s): Composite efficacy failure rate of treated biopsy proven acute rejection (tBPAR), graft loss or death at Month 30, The proportion of patients who remain off immunosuppression for at least 12 months, Incidence, severity, and treatment of acute rejection (derived from the biopsy, rejection, adverse event (AE) and treatment Case Report Forms (CRFs))

Source: https://euclinicaltrials.eu/ctis-public/view/2023-508397-29-00